EU clinical trial 2024-514180-25-00: C4251008 - An Open-label Randomized Phase 3 Study of Tucatinib in Combination with Trastuzumab and mFOLFOX6 versus mFOLFOX6 given with or without either Cetuximab or Bevacizumab as First-line Treatment for Subjects with HER2+ Metastatic Colorectal Cancer
Protocol code: SGNTUC-029
Sponsor: Seagen Inc. (Pharmaceutical company). Phase: Therapeutic confirmatory (Phase III). Countries: Norway (ongoing, recruiting), Netherlands (ongoing, recruiting), Spain (ongoing, recruiting), Slovakia (ongoing, recruiting), Ireland (ongoing, recruiting), Italy (ongoing, recruiting), Austria (ongoing, recruiting), Hungary (ended), France (ongoing, recruiting), Germany (ongoing, recruiting), Poland (ongoing, recruiting), Belgium (ongoing, recruiting), Portugal (ongoing, recruiting), Greece (ongoing, recruiting).
Therapeutic area(s): Diseases [C] - Neoplasms [C04]
Gender: Female, Male. Age: 18-64 years, 65+ years. Enrolment: 155.
Start date (EU): 2022-11-21. Decision date: 2024-06-05. Results received: No. Last updated: 2026-08-03.
Decision dates by country: HU: 2024-06-05, AT: 2024-06-09, PL: 2024-06-07, SK: 2024-06-05, GR: 2024-07-22, NL: 2024-06-05, NO: 2024-06-06, BE: 2024-06-05, IE: 2024-06-06, PT: 2024-06-06, DE: 2024-06-06, ES: 2024-06-10, IT: 2024-06-10, FR: 2024-06-06

Condition(s): unresectable or metastatic HER2+ colorectal cancer
Product: TUKYSA 50 mg film-coated tablets, TUKYSA 150 mg film-coated tablets, Erbitux 5 mg/mL solution for infusion, Herceptin 150 mg powder for concentrate for solution for infusion, Avastin 25 mg/ml concentrate for solution for infusion.

Primary endpoint: PFS per BICR is defined as the time from the date of randomization to the BICR assessment of disease progression according to RECIST v1.1 or death from any cause, whichever occurs first
Endpoint(s): OS, defined as time from randomization to death from any cause (key secondary endpoint), cORR per BICR is defined as the proportion of participants with confirmed CR or PR according to RECIST v1.1, as assessed by BICR. (key secondary endpoint), PFS per INV is defined as time from the date of randomization to the investigator assessment of disease progression according to RECIST v1.1 or death from any cause, whichever occurs first, cORR per INV is defined as the proportion of participants with confirmed CR or PR according to RECIST v1.1, as assessed by investigators., DOR is defined as time from first documentation of objective response (CR or PR that is subsequently confirmed) to the first documentation of disease progression per RECIST v1.1 or death from any cause, whichever occurs earlier., DOR per investigator is based on investigator response assessment and DOR per BICR is based on BICR response., Time to second progression or death (PFS2) is defined as the time from randomization to disease progression on the next-line of therapy, or death from any cause, whichever occurs first, Individual plasma tucatinib concentrations will be used for PK assessments, Change from baseline will be measured for the following PROs scales: global health status/QoL (EORTC QLQ-C30 items 29 and 30) and physical functioning (EORTC QLQ-C30 items 1-5) and time to meaningful change, defined as the time from baseline to the first onset of a ≥10-point changes from baseline in global health status/QoL (EORTC QLQ-C30 items 29 and 30), physical functioning (EORTC QLQ-C30 items 1-5)

Source: https://euclinicaltrials.eu/ctis-public/view/2024-514180-25-00